EU clinical trial 2023-504278-39-00: Montelukast buccal film as disease modifying treatment in mild-moderate Parkinson’s disease (MONTPARK), a double-blind randomized placebo-controlled phase II trial
Sponsor: Karolinska University Hospital (Hospital/Clinic/Other health care facility). Phase: Therapeutic exploratory (Phase II). Countries: Sweden (ongoing, recruiting).
Therapeutic area(s): Diseases [C] - Nervous System Diseases [C10]
Gender: Female, Male. Age: 18-64 years, 65+ years. Enrolment: 98.
Status: Ongoing, recruiting. Start date (EU): 2024-02-27. Decision date: 2023-10-30. Results received: No. Last updated: 2025-07-18.

Condition(s): Parkinson's disease
Product: Montelukast film, Madopark 100 mg/25 mg tabletter, Montelukast 30 mg placebo buccal film

Primary endpoint: The primary outcome is the measurement of motor symptoms using the MDS-UPDRS Part 3, collected in the OFF-medication state at baseline, 6-, 12-, 18- and 21-month visits. The primary endpoint will be the model adjusted estimate for change in motor symptom score from baseline to month 18 across each group
Endpoint(s): MDS-NMS, HADS, evaluated at baseline, 6-, 12-, 18-, and 21-months visit., Adverse events, evaluated continuously, LEDD score calculated at baseline and 18 months

Source: https://euclinicaltrials.eu/ctis-public/view/2023-504278-39-00